EU clinical trial 2024-518338-10-00: The Effect of Albumin Levels on Pharmacokinetics of Cefazolin in Adult Cardiac Surgery: A Prospective, Randomized, Open-label, Parallel-group Pharmacokinetic Study
Protocol code: ALBUCEF
Sponsor: Medical University Of Vienna (Educational Institution). Phase: Therapeutic use (Phase IV). Countries: Austria (ongoing, recruiting).
Therapeutic area(s): Diseases [C] - Cardiovascular Diseases [C14]
Gender: Female, Male. Age: 18-64 years, 65+ years. Enrolment: 20.
Status: Ongoing, recruiting. Start date (EU): 2024-12-10. Decision date: 2024-12-10. Results received: No. Last updated: 2024-12-10.

Condition(s): heart disease, hypoalbuminemia
Product: Human Albumin „CSL Behring“ ® 20 % Infusionslösung, Kefzol 2 g – Trockensubstanz zur Infusionsbereitung

Primary endpoint: The area under the concentration-time curve from 0 - 10h (AUC0-10 ) for free + total drug will be compared between the control and intervention group.

Source: https://euclinicaltrials.eu/ctis-public/view/2024-518338-10-00